EU clinical trial 2023-507754-33-00: Phase 2 Trial to determine the safety and efficacy of simultaneous treatment with ruxolitinib and extracorporeal photopheresis for patients with steroid-refractory chronic Graft-versus-Host-Disease (SR-cGvHD) - RUX-ECP
Protocol code: 1154-RUX-ECP
Sponsor: Medical Center - University Of Freiburg (Hospital/Clinic/Other health care facility). Phase: Therapeutic exploratory (Phase II). Countries: Germany (ongoing, recruiting), Austria (authorised, recruitment pending).
Therapeutic area(s): Diseases [C] - Immune System Diseases [C20]; Diseases [C] - Neoplasms [C04]
Gender: Female, Male. Age: 18-64 years, 65+ years. Enrolment: 40.
Start date (EU): 2025-02-19. Decision date: 2024-10-07. Results received: No. Last updated: 2026-01-21.
Decision dates by country: DE: 2024-10-07, AT: 2024-10-07

Condition(s): steroid-refractory chronic Graft-versus-Host-Disease
Product: Jakavi 10 mg tablets, UVADEX 20 Mikrogramm/ml Lösung zur Modifikation einer Blutfraktion

Primary endpoint: The Overall Response Rate (ORR) at the week 25 (Cycle 7 Day 1) visit. The ORR is defined as the proportion of patients demonstrating a complete response (CR) or partial response (PR) without the requirement of additional systemic therapies for an earlier progression, mixed response or nonresponse. Scoring of response will be relative to the organ score at the time of baseline assessment.
Endpoint(s): To evaluate failure-free survival (FFS), FFS will be used as the first key secondary; FFS is defined as time from start of treatment to the earliest recurrence of underlying disease, start of a new systemic treatment for cGvHD, or death, or the date the patient is last seen alive without event (censored observation), To evaluate change in the modified Lee Symptom Scale score (Symptom control); Response defined as a ≥7-point reduction from baseline in total symptom score (evaluation at week 25)., To assess Overall Survival (OS); OS is defined as time from start of treatment to the date of death from any cause, or the date the patient is last seen alive (censored observation), To assess the best overall response (BOR); Proportion of patients who achieved OR (CR+PR) at any time point (up Cycle 7 day 1 or the start of additional systemic therapy for cGvHD), Response according to organs; Scoring of response will be relative to the organ score at the time of baseline assessment, To assess the duration of response (DOR), Duration of response (DOR) is assessed for responders only. DOR is defined as the time from first response until cGvHD progression, death, or the date of change/addition of systemic therapies for cGvHD, or the date the patient is last seen alive without event (censored observation), To assess the non-relapse mortality (NRM); Non-relapse mortality (NRM) is defined as the time from start of treatment to date of death not preceded by underlying disease relapse/recurrence. Underlying disease relapse/ recurrence is considered as a competing event, To assess the proportion of patients with ≥50% reduction in daily steroid dose at week 25, To assess the proportion of patients who successfully tapered off all steroids at week 25, To assess the cumulative incidence of Malignancy Relapse/Recurrence (MR); Malignancy Relapse/Recurrence (MR) is defined as the time from start of treatment to hematologic malignancy relapse/recurrence. Calculated for patients with underlying hematologic malignant disease. NRM is considered as a competing event., To assess time to treatment response (TTTR), Time to response is defined as time from treatment start to the date of first documentation of PR or CR. Death without prior response will be considered to be a competing event., To assess changes in immune cell phenotype during treatment (only Freiburg), Changes in immune cell phenotype (T cells (CD3, CD4 and CD8), NK cells (CD56, CD3-, TCR-), NKT cells (CD3+ CD1d Tetramer+), monocytes (CD11bCD14); neutrophils (CD11b, CD15)) B cells (CD21low) and immune metabolism during treatment as described in section 7.6.15., To evaluate changes in FACTBMT, Change in FACT-BMT from baseline to each visit where measured.

Source: https://euclinicaltrials.eu/ctis-public/view/2023-507754-33-00